EU clinical trial 2024-519364-40-00: PErsonalized TREatment of high-risk MAmmary Cancer - the PETREMAC trial
Protocol code: PETREMAC
Sponsor: Helse Bergen HF (Hospital/Clinic/Other health care facility). Phase: Therapeutic exploratory (Phase II). Countries: Norway (ongoing, recruitment ended).
Therapeutic area(s): Diseases [C] - Neoplasms [C04]
Gender: Female, Male. Age: 18-64 years, 65+ years. Enrolment: 200.
Status: Ongoing, recruitment ended. Start date (EU): 2024-11-29. Decision date: 2024-11-28. Results received: No. Last updated: 2024-11-28.

Condition(s): Breast cancer
Product: IBRANCE 125 mg hard capsules, IBRANCE 75 mg hard capsules, Lynparza 150 mg film-coated tablets, IBRANCE 100 mg hard capsules, Perjeta 420 mg concentrate for solution for infusion

Primary endpoint: The primary objective of this trial is to prospectively evaluate the predictive and prognostic value of pre-treatment assessment of a panel of 300 known potential driver mutations in breast cancer by next generation sequencing of tumor DNA.
Endpoint(s): To assess how genetic/epigenetic disturbances in tumor tissue change during therapy, The objective response rate (ORR) of personalized medicine, compared to ORR for best standard-of-care using historical data for comparison., Tumor Ki67 reduction after 2 and 5 weeks of treatment in Arm A., To estimate recurrence-free and overall survival when patients are treated with the optimal personalized treatment available as of 2016, using historical data for comparison., To evaluate the percentage of patients completing neoadjuvant treatment as outlined in Figure 1 and completing surgery., Breast conserving surgery rate (potential to avoid mastectomy)., To assess the safety and tolerability of the study treatment given.

Source: https://euclinicaltrials.eu/ctis-public/view/2024-519364-40-00